EU clinical trial 2024-518455-28-00: CBD-OH - Cannabidiol as an add-on treatment during inpatient alcohol cessation in patients with severe alcohol use disorder: a Phase II trial
Protocol code: APHP180619
Sponsor: Assistance Publique Hopitaux De Paris (Hospital/Clinic/Other health care facility). Phase: Therapeutic exploratory (Phase II). Countries: France (ongoing, recruiting).
Therapeutic area(s): Psychiatry and Psychology [F] - Psychological Phenomena [F02]
Gender: Female, Male. Age: 18-64 years, 65+ years. Enrolment: 210.
Status: Ongoing, recruiting. Start date (EU): 2024-07-03. Decision date: 2024-10-24. Results received: No. Last updated: 2025-04-18.

Condition(s): Patients with severe Alcohol Use Disorder (according to DSM 5) at entry of a scheduled inpatient alcohol cessation attempt
Product: Arvisol placebo, Arvisol 150mg

Primary endpoint: Percentage of patients in each group with documented continuous abstinence at month 1 after discharge, week 6 of the study. Continuous abstinence will be defined by patients self-report of alcohol abstinence using standardized TLFB (time line follow back) scales TLFB at screening visit and daily from Day 0 to Day 10 and 4 (1 per week) after discharge up to week 6 of the study), Furthermore, this self-declaration will be confirmed by clinical examination at each study visits assessing acute alcohol intoxication signs and 6 ethyl glucuronide (Et-OH) urinary assessments performed at each study visit (2 during the inpatient stay and 4 (1 per week) after discharge up to week 6 of the study).
Endpoint(s): symptoms check list (PRISE-M) of possible side effects every day from day 1 to 10, and then at each outpatient study visit (4 (1 per week) after discharge up to week 6 of the study). Thus any side effect related to treatment exposure as well as treatment cessation (such as anxiety rebound or withdrawal symptoms related to CBD or increase in cannabis use) could be documented, - in case of relapse: drinking days and drinks per day (self-declared using standardized TLFB time line follow back scale over the past week) at the screening visit and daily from Day 0 to Day 10 and 4 (1 per week) after discharge up to week 6 of the study), - alcohol withdrawal scales and craving scales (CIWA-R, , LIKERT craving scale and an adapt version of the OCDS) at the screening visit and every day from day 0 to 10 then at each study visit: 4 (1 per week) after discharge up to week 6 of the study, - state anxiety scale (STAI-6 the short form of the Spielberger inventory, composed of 6 Likert scales) at the screening visit and every day from day 0 to 10 then at each study visit: 4 (1 per week) after discharge up to week 6 of the study, - Pittsburgh Sleep Quality Index (PSQI) at the screening visit and the last visit. A modified daily version every day from day 0 to 10 then at each study visit a modified weekly version: 4 (1 per week) after discharge up to week 6 of the study, - in the subgroup of patients recruited in AP-HP hospitals, plasmatic level of CBD will be determined twice: at D5 and D10. Analysis of cannabinoids in human biological specimens of plasma will rely on an extraction process and a chromatographic separation in LCMSHR (Liquid chromatography coupled to high resolution mass spectrometry) for quantification of Δ9-tetrahydrocannabinol (THC), cannabidiol (CBD), 11-OH THC and THC-COOH according to guidelines set forth by COFRAC., - self-declared current use of all other substances including tobacco products and nicotine replacement therapies, cannabis, and other substances using standardized TLFB (time line follow back) scales ) at the screening visit and every day from day 0 to 10 then at each study visit: 4 (1 per week) after discharge up to week 6 of the study, - in the subgroup of patients who declare themselves as current cannabis users at entry, urinary quantitative determination of cannabinoids by an extraction process and a chromatographic separation in LCMSHR

Source: https://euclinicaltrials.eu/ctis-public/view/2024-518455-28-00